EU clinical trial 2024-511686-11-00: A 2-year randomized, 3-arm, double-blind, non-inferiority study comparing the efficacy and safety of ofatumumab and siponimod versus fingolimod in pediatric patients with multiple sclerosis followed by an open-label extension
Protocol code: CBAF312D2301
Sponsor: Novartis Pharma AG (Pharmaceutical company). Phase: Therapeutic confirmatory (Phase III). Countries: Croatia (ongoing, recruitment ended), Romania (ended), Austria (ongoing, recruitment ended), Estonia (ongoing, recruitment ended), Latvia (ongoing, recruitment ended), Spain (ongoing, recruitment ended), Portugal (ongoing, recruitment ended), Poland (ongoing, recruitment ended), Slovakia (ongoing, recruitment ended), Italy (ongoing, recruitment ended), Germany (ongoing, recruitment ended), Belgium (ongoing, recruitment ended), France (ongoing, recruitment ended).
Therapeutic area(s): Diseases [C] - Nervous System Diseases [C10]
Gender: Female, Male. Age: 0-17 years. Enrolment: 64.
Start date (EU): 2021-10-05. Decision date: 2024-07-09. Results received: No. Last updated: 2026-03-11.
Decision dates by country: RO: 2024-07-11, AT: 2024-07-15, IT: 2024-07-15, SK: 2024-07-09, PL: 2024-07-18, BE: 2024-07-09, LV: 2024-07-09, PT: 2024-07-10, DE: 2024-07-12, ES: 2024-07-10, HR: 2024-07-09, EE: 2024-07-15, FR: 2024-07-11

Condition(s): Multiple Sclerosis in pediatric patients
Product: BAF312, FINGOLIMOD HYDROCHLORIDE, BAF312, BAF312, Placebo to Ofatumumab (OMB157) [Kesimpta], BAF312, OFATUMUMAB, BAF312, Placebo to Siponimod (BAF312) [Mayzent] film-coated tablets, Placebo to Fingolimod (FTY720) [Gilenya] 0.25mg & 0.5mg, FINGOLIMOD HYDROCHLORIDE

Primary endpoint: Annualized relapse rate (ARR of confirmed relapses)
Endpoint(s): Annualized relapse rate (ARR of confirmed relapses), Number of new or newly enlarging T2 lesions on MRI per year (annualized T2 lesion rate), Neurofilament light chain (NfL) concentration in serum, Ofatumumab and siponimod and (metabolite M17) plasma concentrations, Proportion of participants with anti-ofatumumab antibodies, Adverse events, Columbia Suicide Severity Rating Scale (C-SSRS), ECG, laboratory and ophthalmological data, pulmonary function tests and vital signs

Source: https://euclinicaltrials.eu/ctis-public/view/2024-511686-11-00